EU clinical trial 2023-509629-36-00: A Phase 1b/2, Multicenter, Open-label Study of Ifinatamab Deruxtecan (I-DXd), a B7-H3 Antibody-Drug Conjugate (ADC), in Combination with Atezolizumab with or without Carboplatin as First-line Induction or Maintenance, in Subjects with Extensive‑stage Small Cell Lung Cancer (ES‑SCLC) (IDeate-Lung03).
Protocol code: DS7300-189
Sponsor: Daiichi Sankyo Inc. (Pharmaceutical company). Phase: Phase I and Phase II (Integrated)- Other. Countries: France (ongoing, recruiting), Spain (ongoing, recruiting).
Therapeutic area(s): Diseases [C] - Neoplasms [C04]
Gender: Female, Male. Age: 18-64 years, 65+ years. Enrolment: 48.
Status: Ongoing, recruiting. Start date (EU): 2025-10-29. Decision date: 2024-08-19. Results received: No. Last updated: 2026-05-10.
Decision dates by country: FR: 2024-12-05, ES: 2024-08-19

Condition(s): Extensive-stage Small Cell Lung Cancer (ES-SCLC)
Product: CARBOPLATIN, ATEZOLIZUMAB, ETOPOSIDE, Ifinatamab deruxtecan

Primary endpoint: In the Part A, the endpoints are: DLTs, TEAEs, SAEs, AESIs, ECOG PS, vital sign measurements, standard clinical laboratory parameters (hematology, clinical chemistry, and urinalysis), ECG parameters, ECHO/MUGA scan findings, and ophthalmologic findings., In the Part B, the endpoints are: TEAEs, SAEs, AESIs, ECOG PS, vital sign measurements, standard clinical laboratory parameters (hematology, clinical chemistry, and urinalysis), ECG parameters, ECHO/MUGA scan findings, and ophthalmologic findings.
Endpoint(s): PFS (progression free survival) is defined as the time from the enrollment / randomization date to the earlier of the dates of the first documentation of PD or death due to any cause., ORR (objective response rate) is defined as the proportion of subjects who achieved a BOR of confirmed CR or confirmed PR., DoR (duration of response) is defined as the time from the date of the first documentation of objective response (confirmed CR or confirmed PR) to the date of the first documentation of PD or death due to any cause, whichever occurs first., DCR (disease control rate) is defined as the proportion of subjects who achieved a BOR of confirmed CR, confirmed PR, or SD., CBR (clinical benefit rate) is defined as the proportion of subjects who achieved a BOR of confirmed CR, confirmed PR, or SD lasting for at least 180 days., TTR (time to response) is defined as the time from the date of enrolment / randomization to the date of the first documentation of objective response (confirmed CR or PR) in responding subjects., The best percentage change in the SoD (sum of diameters) of measurable tumors is defined as the percentage change in the smallest SoD from all post-baseline tumor assessments, taking as reference the baseline SoD., OS (overall survival) is defined as the time from the date of enrollment/ randomization to the date of death due to any cause., Plasma concentrations at each time point and PK parameters (Cmax, Tmax, AUClast, and AUCtau). If data permit, AUCinf,t1/2, CL, Vss, Vz, and Kel for I-DXd, total anti-B7-H3 antibody, and MAAA-1181a in the full PK sampling group. Serum concentrations at each time point for atezolizumab (if analyzed)., ADA prevalence (antidrug antibody): the proportion of all subjects having I-DXd ADA at any point in time (including pre-existing ADA at baseline and treatment-emergent ADA). ADA incidence: the proportion of subjects having treatment-emergent ADA during the study period. Titer and neutralizing antibodies may be determined when ADA is confirmed positive. Similar analysis may be conducted for atezolizumab (if analyzed).

Source: https://euclinicaltrials.eu/ctis-public/view/2023-509629-36-00